EU clinical trial 2023-503710-69-00: Effect of antifungals on the intestinal microbiome – a randomized, controlled, proof-of-concept trial
Sponsor: Amsterdam UMC (Hospital/Clinic/Other health care facility). Phase: Therapeutic use (Phase IV). Countries: Netherlands (ongoing, recruiting).
Therapeutic area(s): Analytical, Diagnostic and Therapeutic Techniques and Equipment [E] - Therapeutics [E02]; Phenomena and Processes [G] - Microbiological Phenomena [G06]
Gender: Male. Age: 18-64 years. Enrolment: 50.
Status: Ongoing, recruiting. Start date (EU): 2026-01-05. Decision date: 2023-07-14. Results received: No. Last updated: 2025-07-23.

Condition(s): Not applicable - Healthy Volunteer study
Product: Fluconazol Teva 200 mg, capsules

Primary endpoint: Difference in gut bacteriome and mycobiome composition, ⍺- and ß-diversity between adults treated with an antifungal (fluconazole) and no intervention directly after completion of antifungal treatment (t=14 days).
Endpoint(s): Differences in gut bacteriome and mycobiome composition, ⍺- and ß-diversity between arms and compared to baseline, at 4 weeks after completion of fluconazole treatment, and at 6 months, Differences in gut microbial functional profiles (in the form of metabolic pathways and in vitro faecal microbial fermentation) between arms at the different timepoints, Differences in host systemic innate immune response profiles between arms at the different timepoints. Characterized by, amongst others, ex vivo stimulation assays of peripheral blood mononuclear cells and neutrophils, and measurement of antifungal antibodies

Source: https://euclinicaltrials.eu/ctis-public/view/2023-503710-69-00